EU clinical trial 2024-511110-21-00: A study to test the biological properties of RO7568282 and whether it is safe in healthy participants and participants with Parkinson’s disease.
Protocol code: BP45361
Sponsor: F. Hoffmann-La Roche AG (Pharmaceutical company). Phase: Human Pharmacology (Phase I)- First administration to humans. Countries: Netherlands (ongoing, recruiting), Austria (authorised, recruitment pending), Sweden (authorised, recruitment pending).
Therapeutic area(s): Diseases [C] - Nervous System Diseases [C10]
Gender: Female, Male. Age: 18-64 years, 65+ years. Enrolment: 150.
Start date (EU): 2024-09-09. Decision date: 2024-08-27. Results received: No. Last updated: 2026-07-30.
Decision dates by country: NL: 2024-08-27, AT: 2026-06-21, SE: 2026-06-10

Condition(s): Parkinson’s Disease

Source: https://euclinicaltrials.eu/ctis-public/view/2024-511110-21-00